EU clinical trial 2025-522719-40-00: GAIN-CTNNB1: A Phase I/II open-label trial to evaluate the safety, tolerability, and preliminary efficacy of a single intracerebroventricular administration of an AAV9-based gene replacement therapy in paediatric patients with CTNNB1 syndrome
Protocol code: GAIN-CTNNB1
Sponsor: Fundacija CTNNB1 Ustanova Za Raziskave Na Podrocju Genske Terapije (Laboratory/Research/Testing facility). Phase: Phase I and Phase II (Integrated)- First administration to humans. Countries: Slovenia (ongoing, recruiting).
Therapeutic area(s): Diseases [C] - Nervous System Diseases [C10]; Diseases [C] - Congenital, Hereditary, and Neonatal Diseases and Abnormalities [C16]
Gender: Female, Male. Age: 0-17 years. Enrolment: 12.
Status: Ongoing, recruiting. Start date (EU): 2025-11-21. Decision date: 2025-11-03. Results received: No. Last updated: 2026-03-27.

Condition(s): CTNNB1 syndrome
Product: URBAGEN

Primary endpoint: Incidence, severity, and causality of adverse events and serious adverse events., Occurrence of clinically significant abnormalities in blood (blood count, renal function, liver function, coagulation), urine or CSF compared to baseline., Occurrence of clinically significant changes in cardiorespiratory parameters from baseline., Occurrence of new clinically significant cardiovascular abnormalities on 12-lead electrocardiogram (ECG) or echocardiogram., Occurrence of clinically significant electroencephalographic changes from baseline (EEG)., Occurrence of clinically significant changes in head circumference and significant volumetric changes on MRI brain., Presence of antibodies for AAV9 in serum.
Endpoint(s): To assess the preliminary efficacy of URBAGEN as a single ICV administration in pediatric patients with CTNNB1 syndrome.

Source: https://euclinicaltrials.eu/ctis-public/view/2025-522719-40-00